EU clinical trial 2022-502614-82-00: Bioequivalence of Progesterone Vaginal Insert 100 mg in Healthy Pre-Menopausal, Nonpregnant Female Subjects.
Protocol code: BLCL-PRO-PK-FDA-01
Sponsor: Laboratorios Leon Farma S.A. (Pharmaceutical company). Phase: Human Pharmacology (Phase I)- Bioequivalence Study. Countries: Portugal (ended).
Therapeutic area(s): Not possible to specify
Gender: Female. Age: 18-64 years. Enrolment: 30.
Status: Ended. Start date (EU): 2024-04-18. End date (EU): 2024-07-04. Decision date: 2023-09-26. Results received: No. Last updated: 2024-03-20.

Condition(s): No medical condition.

Source: https://euclinicaltrials.eu/ctis-public/view/2022-502614-82-00